EU clinical trial 2023-504302-11-02: NEoadjuvant Chemotherapy and Immunotherapy for a selected group of inoperable pleural Mesothelioma patients (NECIM): a feasibility study
Sponsor: Antwerp University Hospital (Hospital/Clinic/Other health care facility). Phase: Therapeutic exploratory (Phase II). Countries: Belgium (ongoing, recruiting).
Therapeutic area(s): Diseases [C] - Neoplasms [C04]
Gender: Female, Male. Age: 18-64 years, 65+ years. Enrolment: 37.
Status: Ongoing, recruiting. Start date (EU): 2025-07-22. Decision date: 2025-03-11. Results received: No. Last updated: 2025-11-21.

Condition(s): inoperable pleural mesothelioma
Product: Carboplatine Fresenius Kabi 10 mg/ml concentraat voor oplossing voor infusie, Cisplatin Accord Healthcare 1 mg/ml concentraat voor oplossing voor infusie, YERVOY 5 mg/ml concentrate for solution for infusion, Armisarte 25 mg/ml concentrate for solution for infusion, OPDIVO 10 mg/mL concentrate for solution for infusion.

Primary endpoint: The rate of success, which is defined as a composite endpoint of feasibility (successful completion of 2 cycles of neoadjuvant immunotherapy and chemotherapy, being selected as operable thereafter and having extended P/D), efficacy (being alive and without signs of progressive disease) and safety (no grade 3-4 residual toxicity from systemic treatment and complete resolution of major complications (grade III - V) according to the Ottawa Classification at week 17+/-2weeks after start of treatment
Endpoint(s): Toxicity, assessed by CTC-AE scores and by the Ottawa scores for surgery, Efficacy, assessed by the percentage of T2 and T3 PM patients becoming operable after double neoadjuvant chemotherapy and immunotherapy which is defined by the radiology department using the TNM 9 criteria, Pathological response as graded by light microscopy by an experienced pathologist estimating the percentage of viable tumor cells. Less than 10% viable cells will be considered a major pathological response (MPR). Zero % viable cells will be considered pathological complete response (pCR). RECIST protocol: response evaluation criteria in solid tumors., Progression-free survival (PFS), measured from the date of registration until any progression, Overall survival (OS), measured from the date of registration until death or last available follow-up, Local disease-free survival (DFS), measured from the date of registration until local progression, Quality of life, assessed by the EQ-5D-5L score

Source: https://euclinicaltrials.eu/ctis-public/view/2023-504302-11-02